EU clinical trial 2025-522617-39-00: Phase 1b Study of VERVE-201 in Patients with Refractory Hyperlipidemia
Protocol code: VT-20101
Sponsor: Verve Therapeutics Inc. (Pharmaceutical company). Phase: Human Pharmacology (Phase I)- First administration to humans. Countries: Netherlands (authorised, recruiting).
Therapeutic area(s): Diseases [C] - Cardiovascular Diseases [C14]
Gender: Female, Male. Age: 18-64 years, 65+ years. Enrolment: 10.
Status: Authorised, recruiting. Start date (EU): 2026-07-10. Decision date: 2026-03-30. Results received: No. Last updated: 2026-03-30.

Condition(s): Refractory hyperlipidemia

Source: https://euclinicaltrials.eu/ctis-public/view/2025-522617-39-00